EU clinical trial 2023-504922-20-00: A Phase 3, Open-label Extension Study to Evaluate the Safety and Efficacy of MK-0616 in Adults With Hypercholesterolemia
Protocol code: MK-0616-019
Sponsor: Merck Sharp & Dohme LLC (Pharmaceutical company). Phase: Therapeutic confirmatory (Phase III). Countries: Finland (ongoing, recruitment ended), Italy (ongoing, recruitment ended), Czechia (ongoing, recruitment ended), France (ongoing, recruitment ended), Norway (ongoing, recruitment ended), Netherlands (ongoing, recruitment ended), Germany (ongoing, recruitment ended), Spain (ongoing, recruitment ended), Hungary (ongoing, recruitment ended).
Therapeutic area(s): Diseases [C] - Cardiovascular Diseases [C14]
Gender: Female, Male. Age: 18-64 years, 65+ years. Enrolment: 583.
Status: Ongoing, recruitment ended. Start date (EU): 2024-08-23. Decision date: 2024-08-21. Results received: No. Last updated: 2026-07-13.
Decision dates by country: FI: 2024-08-21, NL: 2024-08-22, HU: 2024-08-26, IT: 2024-08-26, NO: 2024-08-21, DE: 2024-08-22, CZ: 2024-08-22, FR: 2024-08-22, ES: 2024-08-21

Condition(s): Hypercholesterolemia
Product: MK-0616

Primary endpoint: Number of participants with one or more adverse events (AEs), Number of participants who discontinue study drug due to an AE
Endpoint(s): Percent change from baseline of the parent study in low-density lipoprotein cholesterol (LDL-C) at Week 8 of this extension study, Percent change from baseline of the parent study in non-high-density lipoprotein cholesterol (non-HDL-C) at Week 8 of this extension study, Percent change from baseline of the parent study in apolipoprotein B (ApoB) at Week 8 of this extension study, Percent change from baseline of the parent study in lipoprotein(a) (Lp[a]) at Week 8 of this extension study, Percentage of participants with LDL-C <70 mg/dL and ≥50% reduction from baseline of the parent study, Percentage of participants with LDL-C <55 mg/dL and ≥50% reduction from baseline of the parent study

Source: https://euclinicaltrials.eu/ctis-public/view/2023-504922-20-00